EU clinical trial 2025-524048-36-00: Paclitaxel plus ramucirumab and tislelizumab as switch maintenance versus continuation of chemotherapy and tislelizumab in patients with advanced HER2-negative and PD-L1 positive gastroesophageal adenocarcinoma: the ARMANI-2/ENGIC08 trial by GONO
Protocol code: ARMANI-2/ENGIC08
Sponsor: Fondazione GONO G.I. (Patient organisation/association). Phase: Therapeutic confirmatory (Phase III). Countries: Spain (authorised, recruitment pending), Germany (authorised, recruitment pending), Italy (authorised, recruitment pending).
Therapeutic area(s): Diseases [C] - Neoplasms [C04]; Diseases [C] - Digestive System Diseases [C06]
Gender: Female, Male. Age: 18-64 years, 65+ years. Enrolment: 212.
Status: Authorised, recruitment pending. Decision date: 2026-06-18. Results received: No. Last updated: 2026-07-03.
Decision dates by country: DE: 2026-06-22, IT: 2026-06-18, ES: 2026-06-19

Condition(s): Advanced HER2-negative and PD-L1 positive gastroesophageal adenocarcinoma
Product: OXALIPLATIN, FLUOROURACIL, TISLELIZUMAB, CALCIUM FOLINATE, CAPECITABINE, CALCIUM FOLINATE, FLUOROURACIL, TISLELIZUMAB, CISPLATIN, Cyramza 10 mg/ml concentrate for solution for infusion, OXALIPLATIN, PACLITAXEL, CAPECITABINE, Tislelizumab, OXALIPLATIN, FLUOROURACIL, OXALIPLATIN, FLUOROURACIL, CISPLATIN

Primary endpoint: PFS: time from randomization to first documented disease progression per RECIST v1.1 or death, whichever occurs first. Progressive disease is per Investigator assessment. Patients alive without progression at analysis are censored at date of last on-study tumor assessment documenting no progression. Patients with no post-baseline tumor assessments are censored at randomization.
Endpoint(s): OS calculated from the date of randomization to the date of death due to any cause. Alive patients will be censored on the date of last contact., PFS-2 calculated from the date of randomization to the date of disease progression on any treatment given after first disease progression, or death from any cause., Best overall response rate (ORR) is the percentage of patients with RECIST-measurable disease who achieve a complete or partial response per RECIST v1.1 after randomization. Responses are based on investigator-reported measurements. Baseline is the pre-randomization restaging after the 12-week Induction phase. Post-randomization restaging occurs every 8 weeks. ORR is assessed in the ITT population., Disease control rate (DCR) is the percentage of patients achieving complete or partial response or stable disease per RECIST v1.1 during post-induction treatment. Clinical responses are based on investigator-reported measurements. Baseline is the pre-randomization restaging after the 12-week Induction phase. After randomization, restaging occurs every 8 weeks. DCR is assessed in the ITT population., Overall toxicity rate. OTR is defined as the percentage of patients experiencing any treatment- related adverse event, according to NCI-CTCAE v5.0 after randomization. OTR assessed will be assessed in the per protocol population, Other safety endpoints will include, but are not limited to, the following: treatment-emergent adverse events (TEAEs), serious adverse events (SAEs)., Health-related quality of life (HRQoL) will be assessed using PROs: EORTC QLQ-C30, EORTC QLQ-OG25, and EQ-5D. Responses will be collected after randomization and every 8 weeks until disease progression, death, consent withdrawal, or initiation of another anticancer treatment, whichever occurs first., HRQoL will be assessed using Patient Reported Outcomes (PROs), i.e., the European Organization for Research and Treatment of Cancer (EORTC) Quality of Life Questionnaire 30- item core module (EORTC QLQ-C30; 15 dimensions), the EORTC QLQ-OG25, and the EuroQol EQ-5D questionnaires. Responses will be collected after enrollment and at the end of the Induction phase, Proportion of patients who are not eligible for a subsequent treatment after discontinuation of first-line treatment (i.e., attrition rate). Attrition rate will be computed as the percentage of patients without additional anticancer treatments after first-line therapy., PFS and OS will be calculated from randomization based on the best ORR to Induction treatment. ORR is the percentage of patients with RECIST-measurable disease achieving complete or partial response per RECIST v1.1. Responses are based on investigator-reported measurements. Baseline is the screening before enrollment, and restaging occurs at the end of the Induction phase.

Source: https://euclinicaltrials.eu/ctis-public/view/2025-524048-36-00